EU clinical trial 2026-526292-37-01: Phase IV randomized, single-blind clinical trial with three parallel arms to compare ovulation triggering strategies in IVF cycles with fresh embryo transfer.
Protocol code: Triggerbest
Sponsor: Instituto De Investigacion Sanitaria Fundacion Para La Investigacion Del Hospital Clinico De Valencia-INCLIVA (Hospital/Clinic/Other health care facility). Phase: Therapeutic use (Phase IV). Countries: Spain (authorised, recruiting).
Therapeutic area(s): Phenomena and Processes [G] - Reproductive and Urinary Physiological Phenomena [G08]
Gender: Female. Age: 18-64 years. Enrolment: 126.
Status: Authorised, recruiting. Start date (EU): 2026-07-14. Decision date: 2026-07-13. Results received: No. Last updated: 2026-07-13.

Condition(s): Women with infertility and low ovarian reserve.
Product: Orgalutran 0.25 mg/0.5 mL solution for injection, Decapeptyl diario 0,1 mg polvo y disolvente para solución inyectable, REKOVELLE 72 micrograms/2.16 mL solution for injection in a pre-filled pen, Orgalutran 0.25 mg/0.5 mL solution for injection, REKOVELLE 36 micrograms/1.08 mL solution for injection in a pre-filled pen, Orgalutran 0.25 mg/0.5 mL solution for injection, Ovitrelle 250 micrograms solution for injection in pre-filled pen, Ovitrelle 250 micrograms solution for injection in pre-filled pen, Orgalutran 0.25 mg/0.5 mL solution for injection, Orgalutran 0.25 mg/0.5 mL solution for injection, Orgalutran 0.25 mg/0.5 mL solution for injection, REKOVELLE 36 micrograms/1.08 mL solution for injection in a pre-filled pen, REKOVELLE 36 micrograms/1.08 mL solution for injection in a pre-filled pen, Meriofert Kit 900 UI polvo y disolvente para solución inyectable, Orgalutran 0.25 mg/0.5 mL solution for injection, REKOVELLE 36 micrograms/1.08 mL solution for injection in a pre-filled pen, REKOVELLE 72 micrograms/2.16 mL solution for injection in a pre-filled pen, REKOVELLE 72 micrograms/2.16 mL solution for injection in a pre-filled pen, Ovitrelle 250 micrograms solution for injection in pre-filled pen, REKOVELLE 72 micrograms/2.16 mL solution for injection in a pre-filled pen, Orgalutran 0.25 mg/0.5 mL solution for injection, Ovitrelle 250 micrograms solution for injection in pre-filled pen

Primary endpoint: Number of metaphase II (MII) oocytes retrieved at oocyte pickup.
Endpoint(s): Proportion of mature oocytes (MII/total oocytes)., Biochemical pregnancy rate and ongoing pregnancy rate., Gene expression of receptors and enzymes involved in folliculogenesis and ovarian steroidogenesis in mature oocytes.

Source: https://euclinicaltrials.eu/ctis-public/view/2026-526292-37-01